EU clinical trial 2024-519459-27-00: VINORELBINE INHIBITS ONCOGENIC FUNCTIONS OF MKK3: A NEW THERAPEUTIC OPPORTUNITY FOR PATIENTS WITH METASTATIC COLORECTAL CANCER
Protocol code: VIMAC
Sponsor: I.F.O. Istituti Fisioterapici Ospitalieri (Hospital/Clinic/Other health care facility). Phase: Therapeutic exploratory (Phase II). Countries: Italy (authorised, recruitment pending).
Therapeutic area(s): Diseases [C] - Neoplasms [C04]
Gender: Female, Male. Age: 18-64 years, 65+ years. Enrolment: 25.
Status: Authorised, recruitment pending. Decision date: 2025-05-09. Results received: No. Last updated: 2025-05-09.

Condition(s): METASTATIC COLORECTAL CANCER
Product: VINORELBINE, Vinorelbine 30 mg soft capsules

Primary endpoint: ORR is defined as the percentage of patients, relative to the total of enrolled subjects, achieving a complete (CR) or partial (PR) response, according to RECIST 1.1 criteria. The determination of clinical response will be based on investigator-reported measurements. Responses will be evaluated with a chest and abdominal computed tomography (CT) scan every 8 weeks. Patients who do not have an on-study assessment will be included in the analysis as non-responders.
Endpoint(s): Progression-free survival (PFS).Overall survival (OS).Toxicity rate.Quality of Life (QoL) is

Source: https://euclinicaltrials.eu/ctis-public/view/2024-519459-27-00